EU clinical trial 2024-516643-64-00: DIAMOND Study - DIrect oral anticoagulant for Antithrombotic Management Of aortic bioprothesis implanted patients for valvular heart Disease Study
Protocol code: APHP240889
Sponsor: Assistance Publique Hopitaux De Paris (Hospital/Clinic/Other health care facility). Phase: Therapeutic confirmatory (Phase III). Countries: France (ongoing, recruiting).
Therapeutic area(s): Diseases [C] - Cardiovascular Diseases [C14]
Gender: Female, Male. Age: 18-64 years, 65+ years. Enrolment: 1500.
Status: Ongoing, recruiting. Start date (EU): 2026-03-13. Decision date: 2025-05-14. Results received: No. Last updated: 2025-05-14.

Condition(s): Aortic bioprothesis implanted patient for valvular heart disease
Product: Eliquis 5 mg film-coated tablets, ACETYLSALICYLIC ACID

Primary endpoint: The primary endpoint is a composite efficacy endpoint including death, myocardial infarction, stroke, systemic embolism, deep vein thrombosis, or pulmonary embolism and valve thrombosis. The primary endpoint will be evaluated at the end of the treatment (105±15 days after inclusion and randomization).
Endpoint(s): Bleeding (primary safety endpoint) : ISTH major bleeding, Bleeding with ISTH bleeding scale : o ISTH major bleeding o ISTH non-major clinically relevant bleeding, Bleeding with the TIMI bleeding scale : o TIMI major bleeding o TIMI minor bleeding, Bleeding with the BARC definition (BARC 3 to 5), Composite efficacy endpoints including: All-cause death, Myocardial infarction (Fourth Universal Definition of Myocardial Infarction), Stroke, Systemic embolism, Deep vein thrombosis, Pulmonary embolism, Valve thrombosis, All-cause death, Aortic valve thrombosis (adapted from VARC-3 definition), Mean aortic gradient (mmHg) and peak velocity (m/s)

Source: https://euclinicaltrials.eu/ctis-public/view/2024-516643-64-00